EU clinical trial 2023-509688-25-00: Phase IB Study to Assess the Safety, Tolerability and Efficacy of PM14 in combination with Atezolizumab in Pretreated Patients with Selected Advanced Solid Tumors
Protocol code: PM14-A-003-20
Sponsor: Pharma Mar S.A. (Pharmaceutical company). Phase: Human Pharmacology (Phase I)- Other. Countries: Spain (ended).
Therapeutic area(s): Diseases [C] - Neoplasms [C04]
Gender: Female, Male. Age: 18-64 years, 65+ years. Enrolment: 50.
Status: Ended. Start date (EU): 2021-11-23. End date (EU): 2025-09-19. Decision date: 2024-07-23. Results received: No. Last updated: 2025-03-17.

Condition(s): Advanced solid tumors

Source: https://euclinicaltrials.eu/ctis-public/view/2023-509688-25-00